EU clinical trial 2024-515846-18-00: Epi-RCHOP A Phase Ib-II Study of tazemetostat (EPZ-6438) in newly diagnosed Diffuse Large B Cell Lymphoma (DLBCL) or high risk Follicular Lymphoma (FL) patients treated by R-CHOP
Protocol code: Epi-RCHOP
Sponsor: LYSARC (Laboratory/Research/Testing facility). Phase: Phase I and Phase II (Integrated)- First administration to humans. Countries: Belgium (ongoing, recruitment ended), France (ongoing, recruitment ended).
Therapeutic area(s): Diseases [C] - Immune System Diseases [C20]; Diseases [C] - Hemic and Lymphatic Diseases [C15]
Gender: Female, Male. Age: 18-64 years, 65+ years. Enrolment: 214.
Status: Ongoing, recruitment ended. Start date (EU): 2016-09-19. Decision date: 2024-10-07. Results received: No. Last updated: 2026-07-31.
Decision dates by country: BE: 2024-10-08, FR: 2024-10-07

Condition(s): High risk Follicular Lymphoma (FL) patients treated by R-CHOP, Newly diagnosed Diffuse Large B Cell Lymphoma
Product: CYCLOPHOSPHAMIDE, RITUXIMAB, RITUXIMAB, TAZEMETOSTAT, PREDNISOLONE, VINCRISTINE, DOXORUBICIN, RITUXIMAB

Primary endpoint: Incidence and severity of treatment-emergent AEs qualifying as protocol defined DLT’s in cycle 1 and 2 in order to establish the MTD/RP2D
Endpoint(s): PK parameters: maximum plasma concentration (Cmax), time to Cmax (tmax), area under the concentration-time curve from time 0 to last measurable concentration [AUC(0-t)], area under the concentration-time curve from time 0 to 12 hours post-dose [AUC(0-12)], and elimination half-life (t1/2) of cyclophosphamide, prednisolone, doxorubicin, doxorubicinol, methyl prednisolone, prednisone, vincristine, tazemetostat, and EPZ-6930, if data permit, Complete response rate as determined by Cheson IWG 2014: Lugano Classification (Deauville scale 1-3)

Source: https://euclinicaltrials.eu/ctis-public/view/2024-515846-18-00